EU clinical trial 2025-520672-26-00: A Phase 1b/2, multicenter, open-label study to evaluate the efficacy and safety of GSK5764227 alone and in combination in participants with previously treated advanced unresectable or metastatic gastrointestinal solid tumors
Protocol code: 223675
Sponsor: Glaxosmithkline Research & Development Limited (Pharmaceutical company). Phase: Phase I and Phase II (Integrated)- Other. Countries: Belgium (ongoing, recruiting), Italy (ongoing, recruiting), Norway (ongoing, recruiting), Finland (ongoing, recruiting), Poland (ongoing, recruiting), Netherlands (ongoing, recruiting), Germany (ongoing, recruiting), Spain (ongoing, recruiting), France (ongoing, recruiting), Sweden (ongoing, recruiting).
Therapeutic area(s): Diseases [C] - Neoplasms [C04]
Gender: Female, Male. Age: 18-64 years, 65+ years. Enrolment: 176.
Status: Ongoing, recruiting. Start date (EU): 2025-09-16. Decision date: 2025-08-27. Results received: No. Last updated: 2026-05-20.
Decision dates by country: NO: 2025-09-10, PL: 2025-09-08, NL: 2025-09-17, ES: 2025-08-29, SE: 2025-08-28, BE: 2025-08-27, FI: 2025-09-01, FR: 2025-08-28, DE: 2025-08-29, IT: 2025-08-27

Condition(s): Gastrointestinal Neoplasms

Primary endpoint: Confirmed ORR, defined as the proportion of participants who have achieved BOR of confirmed CR or PR as assessed by investigator, according to RECIST 1.1.

Source: https://euclinicaltrials.eu/ctis-public/view/2025-520672-26-00